EU clinical trial 2022-500692-31-00: Beneficial effects of Amiloride on progression of Chronic Kidney Disease: A-CKD
Sponsor: Odense University Hospital (Hospital/Clinic/Other health care facility). Phase: Therapeutic exploratory (Phase II). Countries: Denmark (ongoing, recruiting).
Therapeutic area(s): Diseases [C] - Pathological Conditions, Signs and Symptoms [C23]
Gender: Female, Male. Age: 18-64 years, 65+ years. Enrolment: 40.
Status: Ongoing, recruiting. Start date (EU): 2024-10-10. Decision date: 2023-11-10. Results received: No. Last updated: 2026-08-03.

Condition(s): Chronic kidney disease (CKD)
Product: PLACEBO, MODAMIDE 5 mg, comprimé

Primary endpoint: Urine C3a, Urine soluble C5-9-sTCC/MAC, KIM-1, NGAL
Endpoint(s): Urine albumin/creatinine ratio, Urine protein/creatinine ratio, Blood pressure

Source: https://euclinicaltrials.eu/ctis-public/view/2022-500692-31-00